EU clinical trial 2024-515540-23-00: Epiflux
Sponsor: Medical University Of Vienna (Educational Institution). Phase: Therapeutic exploratory (Phase II). Countries: Austria (ongoing, recruiting).
Therapeutic area(s): Diseases [C] - Nervous System Diseases [C10]
Gender: Female, Male. Age: 18-64 years, 65+ years. Enrolment: 60.
Status: Ongoing, recruiting. Start date (EU): 2020-04-15. Decision date: 2024-10-14. Results received: No. Last updated: 2024-10-14.

Condition(s): Focal epilepsy

Source: https://euclinicaltrials.eu/ctis-public/view/2024-515540-23-00